EU clinical trial 2024-512729-10-00: AcSé pemigatinib: Phase II trial evaluating the efficacy of pemigatinib in patients with recurrent and/or metastatic solid tumor harboring a FGFR alteration
Protocol code: UC-GMP-2305
Sponsor: Unicancer (Hospital/Clinic/Other health care facility). Phase: Therapeutic exploratory (Phase II). Countries: France (ongoing, recruiting).
Therapeutic area(s): Diseases [C] - Neoplasms [C04]
Gender: Female, Male. Age: 18-64 years, 65+ years. Enrolment: 40.
Status: Ongoing, recruiting. Start date (EU): 2025-03-27. Decision date: 2024-10-10. Results received: No. Last updated: 2025-06-10.

Condition(s): Recurrent or metastatic solid cancer harboring a FGFR1,2 ,3 fusion/rearrangement or activating mutation, outside of the approved indications for any selective FGFR inhibitor in France
Product: Pemazyre 4.5 mg tablets

Primary endpoint: Proportion of patients experiencing an objective response or at least a 30% decrease in tumor growth kinetics at PD on study treatment as compared to one calculated from the two pre-treatment tumor evaluations. Tumor kinetics variation is measured by tumor growth ratio (TGr) defined as the ratio of the slope of tumor growth on treatment (between the nadir and PD) and slope of tumor growth before treatment. Sum of diameters of target lesions calculated on each patient's imaging by BICR
Endpoint(s): ORR defined as the proportion of patients with a complete response (CR) or a partial response (PR) as best overall response during the study, based on RECIST1.1, as assessed by the BICR and by the physician., CBR defined as the proportion of patients with a complete response (CR) or a partial response (PR) or a stable disease (SD) lasting ≥ 24 weeks (6 months) as best overall response during the study, based on RECIST1.1, as assessed by the BICR and by the physician., Duration of response (DoR) measured in responder patients from the time of first documented response (CR or PR) until the first documented disease progression (according to RECIST1.1) or death due to any cause, as assessed by the BICR and by the physician., PFS measured from the date of inclusion to the date of event defined as the first documented disease progression (according to RECIST1.1) or death from any cause, whichever occurs first as assessed by the BICR and by physicians. Patients with no event at the time of analysis will be censored at the date of last adequate tumor assessment., TTF defined as the time from the date of inclusion to the date of permanent study treatment discontinuation (any cause, including disease progression, treatment toxicity and death, withdrawal of consent). Patients without treatment failure at the time of the analysis will be censored at the date of last tumor assessment, OS measured from the date of inclusion to the date of death from any cause. Patients who are alive at the time of analysis (including lost to follow-up) will be censored at the date of last contact., Safety and tolerability, as assessed by the occurrence of TEAEs and treatmentrelated AEs according to NCI CTCAE v5.0, QoL (pre, 3- and 6-months post-treatment initiation, and EOT) EORTC QLQ-C30., EXPLORATORY ENDPOINTS: Longitudinal assessment of FGFR alterations on ctDNA.

Source: https://euclinicaltrials.eu/ctis-public/view/2024-512729-10-00